EU clinical trial 2023-506866-30-00: An Open-label, Multicenter, Phase 2 Dose Optimization and Expansion Study to Evaluate the Safety and Efficacy of BB-1701, an anti-human epidermal growth factor receptor 2 (anti-HER2) antibody-drug conjugate (ADC), in Previously Treated Subjects with HER2-positive or HER2-low Unresectable or Metastatic Breast Cancer
Protocol code: BB-1701-G000-205
Sponsor: Eisai Limited (Pharmaceutical company). Phase: Therapeutic exploratory (Phase II). Countries: Spain (ended), Germany (ended), France (ended).
Therapeutic area(s): Diseases [C] - Neoplasms [C04]
Gender: Female, Male. Age: 18-64 years, 65+ years. Enrolment: 45.
Status: Ended. Start date (EU): 2024-08-19. End date (EU): 2025-04-29. End date: 2026-03-18. Decision date: 2024-07-24. Results received: No. Last updated: 2025-04-29.
Decision dates by country: DE: 2024-07-26, FR: 2024-07-24, ES: 2024-07-24

Condition(s): HER2 positive or HER2-low metastatic breast cancer

Primary endpoint: Part 1: Safety: adverse events (AEs), clinical laboratory tests, vital signs, body weight, 12-lead ECGs, ECOG PS., Part 1: Objective response rate (ORR): defined as the proportion of subjects achieving a confirmed CR or confirmed PR by investigator assessment per RECIST 1.1., Part 2: ORR by BICR assessment per RECIST 1.1.
Endpoint(s): Part 1: Duration of response (DOR): defined as the time from the onset date of documented CR or PR for confirmed responses by investigator per RECIST 1.1 to the date of disease progression or death, whichever occurs first., Part 1: PFS: defined as the time from the date of first dose to the date of the first documentation of disease progression by investigator per RECIST 1.1 or death, whichever occurs first, Part 1: Overall survival (OS): defined as the time from the date of first dose to the date of death, Part 1: Disease Control Rate (DCR): defined as the proportion of subjects with CR, PR, or stable disease (SD) (≥5 weeks from the first dose) by investigator per RECIST 1.1, Part 1: Clinical Benefit Rate (CBR): defined as the proportion of subjects with CR, PR, or durable SD (duration of SD ≥23 weeks) by investigator per RECIST 1.1., Part 1: Time To Response (TTR): defined as the time from the date of first dose to the day of the first documented CR or PR for confirmed responses by investigator per RECIST 1.1, Part 1: Noncompartmental PK parameters for BB-1701, total antibody, and eribulin, Part 1: PK/pharmacodynamic relationships for selected efficacy and safety endpoints, Part 2: DOR, DCR, TTR, CBR, and PFS by BICR per RECIST 1.1, Part 2: OS, Part 2: AEs, clinical laboratory tests, vital signs, 12 lead ECG, and ECOG PS

Source: https://euclinicaltrials.eu/ctis-public/view/2023-506866-30-00